EU clinical trial 2024-514481-39-00: MEPI-AVC - Evaluation of the efficacy and safety of mepivacaine on the neurological sequelae of cerabral infarction
Sponsor: Assistance Publique Hopitaux De Paris (Hospital/Clinic/Other health care facility). Phase: Therapeutic exploratory (Phase II). Countries: France (ongoing, recruiting).
Therapeutic area(s): Diseases [C] - Cardiovascular Diseases [C14]
Gender: Female, Male. Age: 18-64 years, 65+ years. Enrolment: 38.
Status: Ongoing, recruiting. Start date (EU): 2024-08-23. Decision date: 2024-08-22. Results received: No. Last updated: 2026-04-22.

Condition(s): Ischemic stroke
Product: CARBOCAINE 20 mg/ml, solution injectable

Primary endpoint: he response is defined as an improvement 1h (+/- 30min) after injection, compared to the evaluation before mepivacaine injection, on at least one of the clinical scores specific to the symptoms: language, motor skills, visual skills

Source: https://euclinicaltrials.eu/ctis-public/view/2024-514481-39-00